EU clinical trial 2025-522295-91-00: HOVON 178 WM: A prospective phase I/II trial of epcoritamab in patients with relapsed or refractory Waldenstrom’s macroglobulinemia
Protocol code: HOVON 178 WM
Sponsor: Hemato-Oncologie voor Volwassenen Nederland (Hovon) Stichting (Patient organisation/association). Phase: Phase I and Phase II (Integrated)- Other. Countries: Denmark (ongoing, recruiting), Belgium (authorised, recruitment pending), Netherlands (ongoing, recruiting).
Therapeutic area(s): Diseases [C] - Neoplasms [C04]
Gender: Female, Male. Age: 18-64 years, 65+ years. Enrolment: 28.
Start date (EU): 2026-06-05. Decision date: 2026-03-10. Results received: No. Last updated: 2026-04-28.
Decision dates by country: BE: 2026-03-10, NL: 2026-03-16, DK: 2026-03-11

Condition(s): relapsed or refractory Waldenstrom’s macroglobulinemia
Product: Epcoritamab (GEN3013), Epcoritamab (GEN3013)

Primary endpoint: Phase Ib: RP2D for epcoritamab based on incidence of DLTs, Phase II: Major response rate (defined as CR, VGPR or PR) after 12 cycles of epcoritamab
Endpoint(s): Phase II: Duration of response (DOR), defined as time from first response to progressive disease (PD) or death from any cause, Phase II: Time to response, time to best response and best response on protocol, Phase II: Categorical response rates (PD, SD, MR, PR, VGPR, CR) after 12 and after 24 cycles of epcoritamab, Phase II: Progression-free survival (PFS), defined as time from start epcoritamab to the first occurrence of disease progression or death from any cause, whichever occurs first, Phase II: Time on treatment (TOT), defined as time from first epcoritamab dose to last administration of epcoritamab, Phase II: Overall survival (OS), defined as the time from start epcoritamab to death from any cause, Phase II: Time to next treatment (TTNT), defined as time from start epcoritamab to next line of WM treatment., Phase II: Treatment free survival (TFS), defined as time from date of last protocol treatment to date start of next (new) line of treatment, or death from any cause, whichever comes first, Phase II: Safety parameters: Type, frequency, and severity of- adverse events (AEs) and- AEs of special interest (AESI) and their relationship to study treatment (determined according to National Cancer Institute (NCI) Common Terminology Criteria for Adverse Events (CTCAE) v5.0), Phase II: Health-related quality of life (QoL) by EORTC QLQ-C30

Source: https://euclinicaltrials.eu/ctis-public/view/2025-522295-91-00